EU clinical trial 2024-514657-30-00: A phase II, monocentric, single arm trial evaluating the efficacy and safety of Pembrolizumab in combination with Lenvatinib in metastatic Uveal MElanoma patients
Protocol code: IC 2020-06
Sponsor: Institut Curie (Hospital/Clinic/Other health care facility). Phase: Therapeutic exploratory (Phase II). Countries: France (ended).
Therapeutic area(s): Diseases [C] - Neoplasms [C04]
Gender: Female, Male. Age: 18-64 years, 65+ years. Enrolment: 54.
Status: Ended. Start date (EU): 2022-07-07. End date (EU): 2026-07-09. Decision date: 2024-07-25. Results received: No. Last updated: 2024-07-25.

Condition(s): Metastatic uveal melanoma

Source: https://euclinicaltrials.eu/ctis-public/view/2024-514657-30-00